EU clinical trial 2024-510939-21-00: Tamibarotene in Combination with Venetoclax and Azacitidine in Previously Untreated Adult Patients Selected for RARA-positive AML Who are Ineligible for Standard Induction Therapy
Protocol code: SY-1425-202
Sponsor: Syros Pharmaceuticals Inc. (Pharmaceutical company). Phase: Therapeutic exploratory (Phase II). Countries: France (ended).
Therapeutic area(s): Diseases [C] - Hemic and Lymphatic Diseases [C15]
Gender: Female, Male. Age: 18-64 years, 65+ years. Enrolment: 60.
Status: Ended. Start date (EU): 2022-04-01. End date (EU): 2024-11-12. Decision date: 2024-04-05. Results received: No. Last updated: 2024-08-30.

Condition(s): RARA-positive acute myeloid leukemia
Product: VENETOCLAX, VENETOCLAX, SY-1425, VENETOCLAX, AZACITIDINE

Primary endpoint: Part 1 Incidence of AEs, changes in clinical laboratory values, ECGs, and vital sign measurements, Part 2 CR/CRi assessment; CR/CRi rate is estimated by the proportion of patients who achieve CR/CRi (as determined by the investigator)
Endpoint(s): Part 1 Overall response assessment, comprised of CR, CRi, CRh, MLFS, or PR (as determined by the investigator); ORR is estimated by the proportion of patients who achieve overall response, Part 1 Tamibarotene PK parameters, Part 2 Incidence of AEs, changes in clinical laboratory values, ECGs, and vital sign measurements, Part 2 CR assessment; CR rate is estimated by the proportion of patients who achieve CR (as determined by the investigator), Part 2 CR/CRh assessment; CR/CRh rate is estimated by the proportion of patients who achieve CR/CRh (as determined by the investigator), Part 2 Duration of CR, defined as duration from the date of first documented evidence of CR to the date of relapse of disease (as determined by the investigator), or death due to any cause, whichever occurs first., Part 2 Duration of CR/CRi, defined as duration from the date of first documented evidence of CR/CRi to the date of relapse of disease (as determined by the investigator), or death due to any cause, whichever occurs first, Part 2 Duration of CR/CRh, defined as duration from the date of first documented evidence of CR/CRh to the date of relapse of disease (as determined by the investigator), or death due to any cause, whichever occurs first, Part 2 Time to CR, defined as the duration from the date of Cycle 1 Day 1 Visit to the date of the first documented evidence of CR as determined by the investigator, Part 2 Time to CR/CRi, defined as the duration from the date of Cycle 1 Day 1 Visit to the date of the first documented evidence of CR/CRi as determined by the investigator, Part 2 Time to CR/CRh, defined as the duration from the date of Cycle 1 Day 1 Visit to the date of the first documented evidence of CR/CRh as determined by the investigator, Part 2 Overall response assessment, comprised of CR, CRi, CRh, MLFS, or PR (as determined by the investigator); ORR is estimated by the proportion of patients who achieve overall response

Source: https://euclinicaltrials.eu/ctis-public/view/2024-510939-21-00